EU clinical trial 2024-517150-10-00: Phase 1/2, Open-label, Dose Escalation and Dose Expansion Study of TransCon TLR7/8 Agonist Alone or in Combination with Pembrolizumab in Participants with Locally Advanced or Metastatic Solid Tumor Malignancies
Protocol code: TCTLR-101
Sponsor: Ascendis Pharma Oncology Division A/S (Pharmaceutical company). Phase: Phase I and Phase II (Integrated)- First administration to humans. Countries: Spain (ended), Netherlands (ended).
Therapeutic area(s): Diseases [C] - Neoplasms [C04]
Gender: Female, Male. Age: 18-64 years, 65+ years. Enrolment: 53.
Status: Ended. Start date (EU): 2023-06-29. End date (EU): 2025-12-02. End date: 2025-12-03. Decision date: 2024-10-03. Results received: No. Last updated: 2025-09-23.
Decision dates by country: ES: 2024-10-03, NL: 2024-10-03

Condition(s): Cancer
Product: KEYTRUDA 25 mg/mL concentrate for solution for infusion, TransCon TLR7/8 Agonist

Primary endpoint: All Parts: Incidence and severity of serious adverse events and adverse events, Parts 1 and 2 Dose Escalation Cohorts: Incidence of dose limiting toxicities (DLTs), Part 3 Neoadjuvant Cohorts (Cohorts 3c and 3d): Pathologic complete response (pCR) per local assessment for pathology review
Endpoint(s): Parts 1 and 2, and Part 3 HNSCC and other HPV-associated tumor types Cohorts (Cohorts 3a and 3b) − Objective response rate (ORR) by RECIST 1.1, duration of response (DoR) and TTR (time to response) per independent central review (ICR)., Parts 1 and 2, and Part 3 HNSCC and other HPV-associated tumor types Cohorts (Cohorts 3a and 3b) - ORR by RECIST 1.1, DoR and TTR per investigator assessment, Parts 1 and 2, and Part 3 HNSCC and other HPV-associated tumor types Cohorts (Cohorts 3a and 3b) − ORR for overall tumor burden, injected and noninjected lesions by itRECIST, DoR, and TTR per investigator assessment, Parts 1 and 2, and Part 3 HNSCC and other HPV-associated tumor types Cohorts (Cohorts 3a and 3b) - Progression free survival (PFS) by RECIST 1.1 per ICR, Parts 1 and 2, and Part 3 HNSCC and other HPV-associated tumor types Cohorts (Cohorts 3a and 3b) - PFS by RECIST 1.1 per investigator assessment, Parts 1 and 2, and Part 3 HNSCC and other HPV-associated tumor types Cohorts (Cohorts 3a and 3b) - Overall survival (OS), Part 3 Neoadjuvant Cohorts (Cohorts 3c and 3d) − pCR per central assessment for pathology review, Part 3 Neoadjuvant Cohorts (Cohorts 3c and 3d) − Major pathologic response (MPR) per local assessment for pathology review, Part 3 Neoadjuvant Cohorts (Cohorts 3c and 3d) − MPR per central assessment for pathology review, Part 3 Neoadjuvant Cohorts (Cohorts 3c and 3d) − Event free survival (EFS) by RECIST 1.1 per investigator assessment, Part 3 Neoadjuvant Cohorts (Cohorts 3c and 3d) - OS, TransCon TLR7/8 Agonist PK parameters

Source: https://euclinicaltrials.eu/ctis-public/view/2024-517150-10-00